EU clinical trial 2023-509494-23-00: DARIUS : A RANDOMIZED NON-COMPARATIVE PHASE II MULTICENTRIC TRIAL ON SHORT TERM DAROLUTAMIDE (ODM-201) CONCOMITANT TO RADIATION THERAPY FOR PATIENTS WITH INTERMEDIATE UNFAVORABLE RISK PROSTATE CANCER
Protocol code: IB 2021-03
Sponsor: Institut Bergonie (Hospital/Clinic/Other health care facility). Phase: Therapeutic exploratory (Phase II). Countries: France (ongoing, recruitment ended).
Therapeutic area(s): Diseases [C] - Neoplasms [C04]
Gender: Male. Age: 18-64 years, 65+ years. Enrolment: 62.
Status: Ongoing, recruitment ended. Start date (EU): 2023-02-20. Decision date: 2024-08-08. Results received: No. Last updated: 2025-10-03.

Condition(s): Adult patients with intermediate unfavorable risk prostate cancer as per NCCN Clinical Practice Guidelines in Oncology (NCCN Guidelines Prostate Cancer. Version 2.2021)
Product: TRIPTORELIN, GONAPEPTYL 3,75 mg, poudre et solvant pour suspension injectable à libération prolongée en seringues pré-remplies., LEUPRORELIN ACETATE, BAY 1841788, TRIPTORELIN, DEGARELIX, LEUPRORELIN ACETATE, TRIPTORELIN, GOSERELIN ACETATE, LEUPRORELIN ACETATE, LEUPRORELIN ACETATE, TRIPTORELIN, GOSERELIN ACETATE, LEUPRORELIN ACETATE, DEGARELIX, LEUPRORELIN ACETATE

Primary endpoint: Efficacy will be assessed in terms of biological response defined as a PSA concentration ≤0.1ng/ml at 6 months post-randomization [23-24].
Endpoint(s): Biochemical disease progression is defined asa PSA level higher than PSA nadir + 2 ng/mL according to Phoenix’s criteria [27]., Biochemical progression-free survival (bPFS) is defined as the delay between the date of randomization and the date of biochemical disease progression or death, whichever comes first. Median bPFS, as well as 2-, 3-, and 5-year bPFS will be reported., Metastasis Free Survival (MFS) is defined as the delay between the date of randomization and the date of metastasis diagnosis (imaging and/or biopsy). Median MFS, as well as 2-, 3- and 5-year MFS will be reported., Disease Free Survival (DFS) is defined as the delay between randomization and the first of the following events: • biological PSA progression defined as level higher than PSA nadir + 2 ng/mL according to Phoenix’s criteria • progression (local, regional, distant) • death (any cause).Median DFS, as well as 2-, 3- and 5-year DFS will be reported., Prostate cancer-specific Survival (PCSS) is defined as the delay between the date of randomization and the date of prostate cancer-related death. Median PCSS, as well as 2-, 3- and 5-year PCSS will be reported., Overall survival is defined as the delay between the date of randomization and the date of death (all cause). Median OS, as well as 2-, 3- and 5-year OS will be reported., Time to testosterone recovery defined as the time from randomization to the time when serum of total testosterone level increases to above the lower limit of the normal range., The safety profile (acute, i.e. < 3 months and late 2-, 3- and 5-year) of each treatment strategy will be graded using NCI CTCAE v5. Both AE and SAE will be coded according to the standardized medical terminology MedDRA., Quality of life will be assessed as follows (M0, M3, M6, M12, M24, M60): o As per the EORTC QLQ-C30 questionnaire and prostate cancer module PR-25 o Assessment of erectile dysfunction, as per IIEF5 [41], o Assessement of symptoms of benign prostatic hyperplasia as per IPSS questionnaire [42], ANCILLARY STUDY : •MRI Radiomics efficacy predictive factors exploratory analysis; testosterone level lowering and recovery at 3, 6 and 9 months post radiotherapy, bone mineral density and score FRAX evolution at M12 and M24 after treatment initiation, FSH and LHlevel at 3, 6, 9 and 15 months post radiotherapy. MRI radiomics efficacy will be centrally analyzed based on multiparametric MRI performed at baseline and M6 (Pr Ulrike Schike, LATIM, Brest)., ANCILLARY STUDY : •FFPE tumor samples will be collected at baseline to assess prognostic value of DECIPHER test in this setting compared to d’Amico and Zumsteg criteria.

Source: https://euclinicaltrials.eu/ctis-public/view/2023-509494-23-00